EU clinical trial 2024-514682-19-00: An open labelled phase III adjuvant trial of disease-free survival in patients with resected pancreatic ductal adenocarcinoma randomized to allocation of oxaliplatin- or gemcitabine-based chemotherapy by standard clinical criteria or by a transcriptomic treatment specific stratification signature (ESPAC-6)
Protocol code: ESPAC-6
Sponsor: Universitaetsklinikum Heidelberg AöR (Hospital/Clinic/Other health care facility). Phase: Therapeutic confirmatory (Phase III). Countries: Germany (authorised, recruitment pending), Sweden (authorised, recruitment pending).
Therapeutic area(s): Diseases [C] - Neoplasms [C04]
Gender: Female, Male. Age: 18-64 years, 65+ years. Enrolment: 394.
Status: Authorised, recruitment pending. Decision date: 2024-11-06. Results received: No. Last updated: 2025-12-16.
Decision dates by country: DE: 2024-11-06, SE: 2024-11-08

Condition(s): Resected pancreatic ductal adenocarcinoma
Product: FLUOROURACIL, OXALIPLATIN, IRINOTECAN, GEMCITABINE, CAPECITABINE, CALCIUM FOLINATE

Primary endpoint: Disease free survival, time from randomization to disease recurrence or death from any cause
Endpoint(s): Overall survival., Metastasis free survival., Overall survival from recurrence., Quality of life (EORTC QLQ C-30)., Assessment of safety: i. Grade 3 and 4 toxicities according to NCI-CTC v.5.0. ii. Adverse and serious adverse events.

Source: https://euclinicaltrials.eu/ctis-public/view/2024-514682-19-00